EU clinical trial 2023-503660-17-00: J1I-MC-GZBN:A Phase 3 Study to Investigate the Efficacy and Safety of LY3437943 Once Weekly in Participants who have Obesity or Overweight and Osteoarthritis of the Knee: A Randomized, Double-Blind, Placebo-Controlled Trial
Protocol code: J1I-MC-GZBN
Sponsor: Eli Lilly & Co. (Pharmaceutical company). Phase: Therapeutic confirmatory (Phase III). Countries: Spain (ended).
Therapeutic area(s): Diseases [C] - Musculoskeletal Diseases [C05]
Gender: Female, Male. Age: 18-64 years, 65+ years. Enrolment: 65.
Status: Ended. Start date (EU): 2023-10-09. End date (EU): 2025-10-28. End date: 2025-11-14. Decision date: 2023-09-15. Results received: No. Last updated: 2026-06-24.

Condition(s): Osteoarthritis, Knee, Obesity, Overweight
Product: Retatrutide, Retatrutide, Retatrutide, Placebo Injection, Retatrutide, Retatrutide

Primary endpoint: Change from Baseline in the Western Ontario and McMaster Universities Osteoarthritis Index (WOMAC) Pain Subscale Score, Percent Change from Baseline in Body Weight

Source: https://euclinicaltrials.eu/ctis-public/view/2023-503660-17-00